EU clinical trial 2023-510191-31-00: PROSTABACT : Relevance of the treatment with antibiotics before endoscopic surgery of lower urinary symptoms related to prostate hypertrophy with polymicrobial bacterial culture performed before the surgery: a non-inferiority randomized trial
Protocol code: DR230286
Sponsor: Centre Hospitalier Regional Universitaire De Tours (Hospital/Clinic/Other health care facility). Phase: Therapeutic confirmatory (Phase III). Countries: France (not authorised).
Therapeutic area(s): Diseases [C] - Male Urogenital Diseases [C12]
Gender: Male. Age: 18-64 years, 65+ years. Enrolment: 380.
Status: Not authorised. Decision date: 2025-02-17. Results received: No. Last updated: 2025-02-17.

Condition(s): Benign Prostate Hyperplasia
Product: FOSFOMYCIN, SULFAMETHOXAZOLE AND TRIMETHOPRIM

Primary endpoint: Incidence over a one-month post-operative period of a symptomatic urinary infection defined by the presence of symptoms validated by a blinded independent adjudication committee (urine burning, fever, urgencies… associated to a significant bacteriuria).
Endpoint(s): Number of patients whose procedure is cancelled in each group, Infection characteristics (type of bacteria, clinical data, hospitalization…), Cost of antibiotics used to treat with antibiotics a polymicrobial UBC performed before endoscopic treatments of BPH and in the one-month post-operative surgical treatment, Probability that the experimental strategy is clinically and economically non-inferior to the control strategy for different values of economic non-inferiority margin and for a constant clinical non-inferiority margin (10%)., Economic impact per year and per cumulative years of a change in prescribing practices for polymicrobial UBC before endoscopic surgery of BPH, from the French Health Insurance perspective, over a 5-year period., Description of baseline urine microbiota in both groups (patients who developed an infection and patients who did not)

Source: https://euclinicaltrials.eu/ctis-public/view/2023-510191-31-00